EU clinical trial 2025-524195-29-00: A randomized, placebo-controlled trial to assess the efficacy, tolerability, and pharmacokinetics of clemastine in children and adults with Pitt-Hopkins syndrome
Protocol code: PTHS-clemastine-01
Sponsor: Amsterdam UMC Stichting (Patient organisation/association). Phase: Therapeutic exploratory (Phase II). Countries: Netherlands (authorised, recruitment pending).
Therapeutic area(s): Diseases [C] - Congenital, Hereditary, and Neonatal Diseases and Abnormalities [C16]; Diseases [C] - Nervous System Diseases [C10]
Gender: Female, Male. Age: 0-17 years, 18-64 years, 65+ years. Enrolment: 40.
Status: Authorised, recruitment pending. Decision date: 2026-04-13. Results received: No. Last updated: 2026-04-13.

Condition(s): Pitt-Hopkins syndrome
Product: microcrystalline cellulose, Tavegyl 1 mg, tabletten

Primary endpoint: Caretaker Global Impression rating scale (CaGI)
Endpoint(s): Clinical Global Impression rating scale (CGI), PROMIS Custom Short Form – Fatigue; Numeric Rating Scale (NRS) – Fatigue, Aberrant Behavior Checklist; EuroQol-5D-Y-5L; PROMIS Early Childhood Parent Report v1.0 – Child-Caregiver Interactions; PROMIS Early Childhood Parent Report v1.0 – Anxiety; PROMIS Early Childhood Parent Report v1.0 – Depressive Symptoms, PROMIS Early Childhood Parent Report v1.0 - Sleep disturbance; Numeric Rating Scale (NRS) – Sleep; Pediatric Quality of Life Inventory (PedsQL) Gastrointestinal Symptoms questionnaire, ‘stomach pain and hurt’, ‘heart burn and reflux’, ‘gas and bloating’, and ‘constipation’ scales; Rett-syndrome Behavior Questionnaire, Breathing Problems (RSBQ-BP), adapted for PTHS ;Number and type of epileptic seizures during past 30 days, Gross Motor Function Measure (GMFM-88); Two minute walking test, Resting-state electroencephalography (EEG) recording: power spectrum, long term temporal correlations and network level excitation-inhibition dynamics, Pharmacokinetic parameters such as maximum concentration (Cmax), area under the concentration-time curve (AUC), half-life and predicted trough concentration (Ctrough) at steady state, using nonlinear mixed effects modelling (NONMEM)., IMTA Medical Consumption Questionnaire (iMCQ); IMTA Productivity Cost Questionnaire (iPCQ), Semi-structured, qualitative interviews, The relationship between clemastine PK and safety/efficacy-related biomarkers

Source: https://euclinicaltrials.eu/ctis-public/view/2025-524195-29-00